EU clinical trial 2024-512318-16-00: Neo-adjuvant intraperitoneal chemotherapy (irinotecan) and systemic chemotherapy (mFOLFOX4-bevacizumab) prior to CRS-HIPEC for patients with isolated resectable colorectal peritoneal metastases: a multicentre, phase II trial (INTERACT-PLUS)
Protocol code: 2024-512318-16-00
Sponsor: Erasmus Universitair Medisch Centrum Rotterdam (Erasmus MC) (Hospital/Clinic/Other health care facility). Phase: Therapeutic exploratory (Phase II). Countries: Netherlands (authorised, recruitment pending).
Therapeutic area(s): Diseases [C] - Neoplasms [C04]
Gender: Female, Male. Age: 18-64 years, 65+ years. Enrolment: 40.
Status: Authorised, recruitment pending. Decision date: 2024-10-10. Results received: No. Last updated: 2026-01-02.

Condition(s): Patients with colorectal peritoneal metastases with a PCI-score of 1-20
Product: Calcium Folinate 10 mg/ml Solution for injection or infusion, Irinotecanhydrochloridetrihydraat Hikma 20 mg/ml, concentraat voor oplossing voor infusie, Fluorouracil Accord 50 mg/ml, oplossing voor injectie of infusie, Avastin 25 mg/ml concentrate for solution for infusion., Oxaliplatin Eugia 5 mg/ml concentraat voor oplossing voor infusie

Primary endpoint: The number of patients that is able to undergo all trial treatments (minimally 4 cycles of IP and systemic chemotherapy, followed by CRS-HIPEC)
Endpoint(s): Measured toxicity in patients during trial treatments (measured by the amount of AE/SAE and SUSAR), Pathological response after trial treatment (assessed by the MANDARD scoring system and the Tumor Regression Grading System), Radiologic response measured by RECIST and PERCIST (ceCT vs. PET/CT), Comparison of PCI-scores of the diagnostic laparoscopy, CRS-HIPEC, PET-CT and CT, Quality of life assessment via EQ-5D-5L, QLQ-C30, QLQ-CR29, iMTA productivity cost questionnaire (PCQ), and iMTA medical consumption questionnaire (MCQ) at selected points during the trial, Disease free survival, after CRS-HIPEC, with a follow-up of 6 months

Source: https://euclinicaltrials.eu/ctis-public/view/2024-512318-16-00